EU clinical trial 2024-510644-31-00: To Evaluate the Safety and Pharmacokinetics of XMAB24306 in Combination with Daratumumab in Patients with Relapsed/Refractory Multiple Myeloma
Protocol code: GO43073
Sponsor: Genentech Inc. (Pharmaceutical company). Phase: Human Pharmacology (Phase I)- Other. Countries: Norway (ended), Denmark (ended), Spain (ended).
Therapeutic area(s): Diseases [C] - Neoplasms [C04]
Gender: Female, Male. Age: 18-64 years, 65+ years. Enrolment: 50.
Status: Ended. Start date (EU): 2022-06-10. End date (EU): 2024-05-14. End date: 2024-07-10. Decision date: 2024-04-17. Results received: No. Last updated: 2024-04-22.
Decision dates by country: DK: 2024-04-18, ES: 2024-04-22, NO: 2024-04-17

Condition(s): Relapsed/Refractory Multiple Myeloma

Source: https://euclinicaltrials.eu/ctis-public/view/2024-510644-31-00